EU clinical trial 2023-504204-28-00: Evaluation of the postoperative analgesic efficacy of erector spinae plane block in lumbar spinal surgery: a prospective randomized double-blind study
Sponsor: CHU De Liege (Hospital/Clinic/Other health care facility). Phase: Therapeutic use (Phase IV). Countries: Belgium (ongoing, recruiting).
Therapeutic area(s): Analytical, Diagnostic and Therapeutic Techniques and Equipment [E] - Anesthesia and Analgesia [E03]
Gender: Female, Male. Age: 18-64 years, 65+ years. Enrolment: 126.
Status: Ongoing, recruiting. Start date (EU): 2023-10-17. Decision date: 2023-09-19. Results received: No. Last updated: 2024-09-04.

Condition(s): Patients undergoing lumbar arthrodesis
Product: Etoricoxib AB 60 mg comprimés pelliculés, MORPHINE HCl STEROP 10mg/1ml Solution injectable, Paracetamol Fresenius Kabi 10 mg/ml oplossing voor infusie, Rocuronium B. Braun 10 mg/ml oplossing voor injectie / infusie, Levobupivacaine Fresenius Kabi 5 mg/ml Injektionslösung / Infusionslösung, TRADONAL, 100 mg, solution injectable, Solu-Medrol S.A.B. (= Sine Alcohol Benzylicus) Act-O-Vial 125 mg Poudre et solvant pour solution injectable (méthylprednisolone), Propolipid 1% emulsie voor injectie of infusie, Chlorure de sodium 0,9% Fresenius Kabi solvant pour préparation parentérale, Linisol 1 %, oplossing voor injectie, Sévoflurane Baxter 100 %, liquide pour inhalation par vapeur, Sufentanil Mylan 5 Mikrogramm/ml Injektionslösung

Primary endpoint: The primary objective will define wether or not ESPB is effective at reducing opioid consumption, in morphine oral equivalent, during the first 24 hours postoperatively
Endpoint(s): Analysis of intraoperative parameters (blood pressure, heart rate, Response and State Entropy (RE/SE), Surgical Plethysmographic Index (SPI) at the time of the block, during incision and at extubation., Absence of complications related to the block, Opioid use in the PACU, Level of drowsiness in PACU (RASS score), Pain scores at different time intervals from PACU to hospital discharge, Length of hospitalization, Assessment of the quality of postoperative recovery using the QoR-15 score at PCA withdrawal, Presence of PONV, constipation, pruritus

Source: https://euclinicaltrials.eu/ctis-public/view/2023-504204-28-00